EU clinical trial 2023-505261-84-00: EORTC-1809-STBSG: A randomized phase III study of neoadjuvant chemotherapy followed by surgery versus surgery alone for patients with High Risk RetroPeritoneal Sarcoma (STRASS 2)
Protocol code: EORTC-1809-STBSG
Sponsor: European Organisation For Research And Treatment Of Cancer (Patient organisation/association). Phase: Therapeutic confirmatory (Phase III). Countries: Denmark (ongoing, recruiting), Germany (ongoing, recruiting), Czechia (ongoing, recruiting), Spain (ongoing, recruiting), Italy (ongoing, recruiting), Netherlands (ongoing, recruiting), Cyprus (ended), Slovakia (ongoing, recruiting), France (ongoing, recruiting), Poland (ongoing, recruiting).
Therapeutic area(s): Diseases [C] - Neoplasms [C04]
Gender: Female, Male. Age: 18-64 years, 65+ years. Enrolment: 180.
Start date (EU): 2020-10-06. Decision date: 2023-08-31. Results received: No. Last updated: 2026-07-07.
Decision dates by country: CY: 2023-08-31, DK: 2023-09-01, NL: 2023-09-07, ES: 2023-09-01, SK: 2023-09-13, IT: 2023-09-06, DE: 2023-09-05, PL: 2023-10-16, CZ: 2023-08-31, FR: 2023-10-05

Condition(s): Primary high risk leiomyosarcoma or liposarcoma of retroperitoneal space or infra-peritoneal spaces of pelvis
Product: DACARBAZINE, IFOSFAMIDE, IFOSFAMIDE, IFOSFAMIDE, IFOSFAMIDE, EPIRUBICIN HYDROCHLORIDE, DACARBAZINE, DOXORUBICIN HYDROCHLORIDE, DACARBAZINE, IFOSFAMIDE, IFOSFAMIDE, IFOSFAMIDE, DACARBAZINE

Primary endpoint: Disease free survival (which includes as events: distant progression on neoadjuvant treatment, local progression if not followed by R0/R1 surgery, non-operable tumours, local recurrence and/or distant metastases, R2 and death)
Endpoint(s): Overall survival, Recurrence free survival, Distant metastases free survival, Cumulative incidence of local recurrences, Cumulative incidence of distant metastases, Radiological response to neoadjuvant chemotherapy according to RECIST, Radiological response to neoadjuvant chemotherapy according to CHOI, Pathological response, Safety and toxicity of neoadjuvant chemotherapy, Perioperative complications, Late complications, Health-Related Quality of life (EORTC QLQ-C30 + Item list from QLQ-STO22), Health utility, calculated from the collected patient-reported HRQoL data and patient demographics economics.

Source: https://euclinicaltrials.eu/ctis-public/view/2023-505261-84-00